EU clinical trial 2023-506233-30-01: A study in people with overweight or obesity to test how BI 1820237, BI 456906, or a combination of both affects brain activity
Protocol code: 1458-0006
Sponsor: Boehringer Ingelheim International GmbH (Pharmaceutical company). Phase: Human Pharmacology (Phase I)- Other. Countries: Germany (ended).
Therapeutic area(s): Diseases [C] - Nutritional and Metabolic Diseases [C18]
Gender: Female, Male. Age: 18-64 years. Enrolment: 24.
Status: Ended. Start date (EU): 2024-04-15. End date (EU): 2025-02-24. Decision date: 2024-03-20. Results received: No. Last updated: 2024-08-07.

Condition(s): Obesity

Source: https://euclinicaltrials.eu/ctis-public/view/2023-506233-30-01